EU clinical trial 2024-510701-29-00: Randomized Clinical Trial of the use of Propofol as a sedative agent versus spinal analgesia with bupivacaine in External Cephalic Version (PropoSpinECV)
Protocol code: IMIB-ECV-2024-01
Sponsor: Fundacion Para La Formacion E Investigacion Sanitaria De La Region De Murcia (Educational Institution). Phase: Therapeutic use (Phase IV). Countries: Spain (ongoing, recruiting).
Therapeutic area(s): Diseases [C] - Female Urogenital Diseases and Pregnancy Complications [C13]
Gender: Female. Age: 18-64 years. Enrolment: 270.
Status: Ongoing, recruiting. Start date (EU): 2024-07-04. Decision date: 2024-05-20. Results received: No. Last updated: 2024-05-20.

Condition(s): External Cephalic Version
Product: Bupivacaína B. Braun 5 mg/ml solución inyectable, Propofol Fresenius 10 mg/ml emulsión para inyección o perfusión, Fentanest 0,05 mg/ml solución inyectable

Primary endpoint: The primary end point is the ECV outcome.
Endpoint(s): Secondary outcome variables are complications of ECV, urgent cesarean section during the first 24 hours after the procedure, VAS scale, postoperative pain survey, clinically relevant hypotension, nausea, vomiting.

Source: https://euclinicaltrials.eu/ctis-public/view/2024-510701-29-00